EU clinical trial 2023-507239-39-00: A clinical study of MK-1403 in healthy people (MK-1403-002)
Protocol code: MK-1403-002
Sponsor: Merck Sharp & Dohme LLC (Pharmaceutical company). Phase: Human Pharmacology (Phase I)- Other. Countries: Belgium (ended).
Therapeutic area(s): Diseases [C] - Cardiovascular Diseases [C14]
Gender: Female, Male. Age: 18-64 years. Enrolment: 56.
Status: Ended. Start date (EU): 2025-04-25. End date (EU): 2025-09-09. End date: 2025-09-10. Decision date: 2025-04-17. Results received: No. Last updated: 2025-09-02.

Condition(s): Atherosclerosis

Source: https://euclinicaltrials.eu/ctis-public/view/2023-507239-39-00